EU clinical trial 2024-515236-69-00: Randomized comparison of short versus 12 months prasugrel plus aspirin in patients with acute coronary syndromes treated with percutaneous coronary intervention and everolimus-eluting stents
Sponsor: Odense University Hospital (Hospital/Clinic/Other health care facility). Phase: Phase III and phase IV (Integrated). Countries: Denmark (ended).
Therapeutic area(s): Diseases [C] - Cardiovascular Diseases [C14]
Gender: Female, Male. Age: 18-64 years, 65+ years. Enrolment: 3150.
Status: Ended. Start date (EU): 2024-12-13. End date (EU): 2025-10-17. Decision date: 2024-08-23. Results received: No. Last updated: 2024-08-23.

Condition(s): Acute coronary syndromes
Product: Hjertemagnyl, filmovertrukne tabletter 75 mg, Prasugrel Krka 10 mg film-coated tablets

Primary endpoint: Assessed between 1 and 12 months after PCI Effectiveness: Clinically relevant bleeding (BARC 2, 3 and 5 ). Powered for superiority, Assessed between 1 and 12 months after PCI Safety: Composite major adverse cardiovascular or cerebrovascular events (MACCE) (a composite of cardiac death, myocardial infarction, definite stent thrombosis, ischemic stroke or clinically driven target lesion revascularization). Powered for non-inferiority.
Endpoint(s): Individual components of the primary end point comprised the secondary end points, Stent thrombosis rate according to the Academic Research Consortium-2 definition, Major bleeding (BARC type 2, 3 and 5), Health-related quality of life, Angina status based on the Canadian Cardiovascular Society classification system

Source: https://euclinicaltrials.eu/ctis-public/view/2024-515236-69-00